EU clinical trial 2026-526526-41-01: Within-Patient Comparison of Serum Transthyretin Response to Tafamidis Versus Acoramidis: A Pilot Crossover Study in Transthyretin Amyloid Cardiomyopathy (ATTR-CM)
Sponsor: Medical University Of Vienna (Educational Institution). Phase: Therapeutic use (Phase IV). Countries: Austria (authorised, recruitment pending).
Therapeutic area(s): Diseases [C] - Cardiovascular Diseases [C14]
Gender: Female, Male. Age: 18-64 years, 65+ years. Enrolment: 10.
Status: Authorised, recruitment pending. Decision date: 2026-07-27. Results received: No. Last updated: 2026-07-27.

Condition(s): Transthyretin Amyloid Cardiomyopathy (ATTR-CM)
Product: BEYONTTRA 356 mg film-coated tablets, Vyndaqel 61 mg soft capsules

Primary endpoint: The primary endpoint of this study is the absolute change in serum TTR concentration (mg/dL) from baseline (pre-dose, day 0) to week 4 (day 28 ±5) after initiation of treatment with tafamidis and acoramidis. The pre-specified primary endpoints are the absolute change, with relative (%) change reported as supportive.

Source: https://euclinicaltrials.eu/ctis-public/view/2026-526526-41-01